EU clinical trial 2022-502969-19-00: An Open-Label, Single-Center, Single-Dose Study to Assess the Absolute Oral Bioavailability and Pharmacokinetics of Aticaprant Administered as an Oral Tablet and an Intravenous Infusion Microdose of 14C-Aticaprant in Healthy Participants
Protocol code: 67953964MDD1008
Sponsor: Janssen - Cilag International (Pharmaceutical company). Phase: Human Pharmacology (Phase I)- Other. Countries: Belgium (ended).
Therapeutic area(s): Psychiatry and Psychology [F] - Mental Disorders [F03]
Gender: Female, Male. Age: 18-64 years. Enrolment: 10.
Status: Ended. Start date (EU): 2023-09-27. End date (EU): 2023-11-03. Decision date: 2023-09-04. Results received: Yes. Last updated: 2023-09-04.

Condition(s): Healthy Adult Participants
Product: JNJ-67953964, JNJ-67953964

Primary endpoint: Absolute bioavailability (Fabs).

Source: https://euclinicaltrials.eu/ctis-public/view/2022-502969-19-00